EU clinical trial 2023-510215-18-00: RElapse from Mrd Negativity As iNdication for Treatment
Protocol code: OMC01/19
Sponsor: Oslo University Hospital HF (Hospital/Clinic/Other health care facility). Phase: Phase II and Phase III (Integrated). Countries: Norway (ongoing, recruitment ended), Lithuania (ongoing, recruitment ended).
Therapeutic area(s): Diseases [C] - Immune System Diseases [C20]; Diseases [C] - Neoplasms [C04]
Gender: Female, Male. Age: 18-64 years, 65+ years. Enrolment: 391.
Status: Ongoing, recruitment ended. Start date (EU): 2024-09-26. Decision date: 2024-09-26. Results received: No. Last updated: 2026-06-10.
Decision dates by country: LT: 2024-10-23, NO: 2024-09-26

Condition(s): Multiple myeloma
Product: BETAMETHASONE DISODIUM PHOSPHATE, CARFILZOMIB, Dexametason Abcur 1 mg tabletter, DARATUMUMAB, Lenalidomide Mylan 25 mg hard capsules, Bortezomib Accord 3.5 mg powder for solution for injection, LENALIDOMIDE

Primary endpoint: Part 1: 1. The number of patients who achieve MRD negativity measured by Euroflow at 30-45 days after the 4th cycle of consolidation therapy has started., Part 2: 1. PFS rate of Arm A (MRD guided) vs Arm B defined as the time from randomization to disease progression or death due to any cause following 2.L treatment. 2. OS rate of Arm A (MRD guided) vs Arm B defined as the time from randomization to death of any cause following 2.L treatment.
Endpoint(s): Part 1: 1. The PFS rate of patients receiving 4 cycles of VRd as consolidation 2. The OS rate of patients receiving 4 cycles of VRd as consolidation 3. The number of AEs and relevant laboratory parameters monitored at every visit from entry into part 1 of the study until end of part 1 4. The proportion of patients who achieve PR or better following 4 cycles of VRd consolidation treatment, Part 2: 1.Time from randomization to start of 3.L therapy (TTNT) 2.The proportion of patients who achieve MRD negativity during 2.L treatment, monitored by MRD Euroflow at 6 and 18 months in arm A, and after achieving CR in arm B (first MRD testing after 6 months). 3.Patient reported outcome HRQOL forms will be filled out by patients at defined time points during the study and finally at relapse after 2.L therapy. 4.The number of AEs

Source: https://euclinicaltrials.eu/ctis-public/view/2023-510215-18-00